EU clinical trial 2024-514073-22-01: Differences in coagulation between fresh frozen plasma and Solvent-detergent plasma in pediatric congenital heart surgery
Sponsor: Erasmus Universitair Medisch Centrum Rotterdam (Erasmus MC) (Hospital/Clinic/Other health care facility). Phase: Therapeutic confirmatory (Phase III). Countries: Netherlands (ongoing, recruiting).
Therapeutic area(s): Diseases [C] - Hemic and Lymphatic Diseases [C15]
Gender: Female, Male. Age: 0-17 years. Enrolment: 120.
Status: Ongoing, recruiting. Start date (EU): 2024-09-23. Decision date: 2024-09-23. Results received: No. Last updated: 2026-05-22.

Condition(s): Coagulation in pediatric cardiac surgery
Product: PLASMA, Omniplasma 45-70 mg/ml oplossing voor infusie

Primary endpoint: Primary outcome involves the difference of coagulation variables measured just after surgery between FFP or Omniplasma use. The coagulation variables of interest are protein C activity, protein S activity, α2-antiplasmin, antithrombin, plasminogen, Hb, thrombocyte count, ROTEM, aPTT, PT and fibrinogen.

Source: https://euclinicaltrials.eu/ctis-public/view/2024-514073-22-01